EU clinical trial 2024-511744-27-00: A Phase 1 open-label, first-in-human, multi-center, dose escalation and dose expansion study of CLN-619 administered alone or in combination with pembrolizumab in patients with advanced solid tumors.
Protocol code: CLN-619-001
Sponsor: Cullinan Mica Corp. (Pharmaceutical company). Phase: Human Pharmacology (Phase I)- First administration to humans. Countries: Spain (ended), Poland (ended).
Therapeutic area(s): Diseases [C] - Neoplasms [C04]
Gender: Female, Male. Age: 18-64 years, 65+ years. Enrolment: 240.
Status: Ended. Start date (EU): 2022-06-27. End date (EU): 2025-12-29. End date: 2025-12-30. Decision date: 2024-03-29. Results received: No. Last updated: 2025-11-19.
Decision dates by country: PL: 2024-03-29, ES: 2024-04-02

Condition(s): Solid tumors, Non-Small Cell Lung Cancer, Cervical Cancer, Endometrial Cancer, Ovarian Cancer, breast cancer, gastrointestinal cancer

Source: https://euclinicaltrials.eu/ctis-public/view/2024-511744-27-00